EU clinical trial 2022-500121-33-01: A Phase 3 open-label, controlled, randomised, multi-centre trial comparing imlifidase and standard-of-care with standard-of-care alone in the treatment of severe anti-GBM antibody disease (Goodpasture disease)
Protocol code: 21-HMedIdeS-24
Sponsor: Hansa Biopharma AB (Pharmaceutical company). Phase: Therapeutic confirmatory (Phase III). Countries: Spain (ended), Czechia (ended), Germany (ended), France (ended), Italy (ended), Sweden (ended), Netherlands (ended), Austria (ended), Belgium (ended), Denmark (ended), Ireland (ended), Poland (ended).
Therapeutic area(s): Diseases [C] - Immune System Diseases [C20]
Gender: Female, Male. Age: 18-64 years, 65+ years. Enrolment: 35.
Status: Ended. Start date (EU): 2023-05-08. End date (EU): 2026-02-02. End date: 2026-02-03. Decision date: 2023-03-21. Results received: No. Last updated: 2026-02-05.
Decision dates by country: AT: 2023-09-18, FR: 2023-04-26, DK: 2023-08-23, CZ: 2023-03-21, IT: 2023-04-26, PL: 2023-09-18, ES: 2023-03-22, NL: 2023-04-26, IE: 2023-09-18, SE: 2023-04-26, BE: 2023-08-11, DE: 2023-04-26

Condition(s): Anti-GBM antibody disease (Goodpasture disease)
Product: TRIMETHOPRIM, SULFAMETHOXAZOLE, PREDNISOLONE, CYCLOPHOSPHAMIDE, METHYLPREDNISOLONE, Idefirix 11 mg powder for concentrate for solution for infusion, LORATADINE

Primary endpoint: Renal function as evaluated by eGFR at 6 months
Endpoint(s): Proportion of patients with functioning kidney at 6 months, i.e. no dialysis events within 4 weeks prior to assessment, Time to non-toxic level of anti-GBM antibodies, Exposure to toxic level of anti-GBM antibodies, Renal function as evaluated by eGFR at 3 months, Proportion of patients with functioning kidney at 3 months, i.e. no dialysis event within 4 weeks prior to assessment, Proportion of patients experiencing ESRD or death due to anti-GBM disease within 6 months, Urine creatinine clearance from randomisation to 3 and 6 months, U-albumin at 3 and 6 months (24h collection), U-albumin/creatinine ratio at screening and during study (morning urine void), Renal function as evaluated by eGFR at screening and during study, Number of PLEX sessions within 3 months from randomisation, Number of days on dialysis within 3 and 6 months from randomisation, Proportion of patients being negative during study for: Anti-GBM antibodies; ANCA;Anti-GBM antibodies and ANCA, Number of days with mechanical ventilation due to anti-GBM disease within 3 months from randomisation, Number of days at ICU and number of days in hospitalisation from randomisation to 3 months, HRQoL and health status as evaluated by PROMIS-29 and EQ-5D-5L from screening to 6 months, Imlifidase PK data from start of imlifidase treatment to Day 15, Imlifidase PD (IgG) profile from start of imlifidase treatment to Day 15, Anti-imlifidase antibody levels from start of imlifidase treatment to 6 months

Source: https://euclinicaltrials.eu/ctis-public/view/2022-500121-33-01